EU clinical trial 2023-506987-15-00: Phase Ib/II Trial of Pembrolizumab (MK-3475) Combination Therapies in Metastatic Castration-Resistant Prostate Cancer (mCRPC) (KEYNOTE-365)
Protocol code: MK-3475-365
Sponsor: Merck Sharp & Dohme LLC (Pharmaceutical company). Phase: Phase I and Phase II (Integrated)- Other. Countries: Poland (ongoing, recruitment ended), Germany (ongoing, recruitment ended), France (ended), Finland (ended), Italy (ongoing, recruitment ended), Ireland (ongoing, recruitment ended), Sweden (ongoing, recruitment ended), Austria (ended), Spain (ongoing, recruitment ended), Netherlands (ongoing, recruitment ended), Denmark (ongoing, recruitment ended).
Therapeutic area(s): Diseases [C] - Neoplasms [C04]
Gender: Male. Age: 18-64 years, 65+ years. Enrolment: 294.
Start date (EU): 2016-11-17. Decision date: 2024-04-09. Results received: No. Last updated: 2026-04-17.
Decision dates by country: AT: 2024-04-15, FI: 2024-04-10, FR: 2024-04-15, IE: 2024-04-09, ES: 2024-04-09, DK: 2024-04-10, IT: 2024-05-28, NL: 2024-04-09, SE: 2024-04-15, DE: 2024-04-15, PL: 2024-04-12

Condition(s): Metastatic Castration-Resistant Prostate Cancer
Product: CARBOPLATIN, ETOPOSIDE, ENZALUTAMIDE, KEYTRUDA 25 mg/mL concentrate for solution for infusion, Olaparib, MK-7684A, DOCETAXEL, Belzutifan, Lenvatinib, Lenvatinib, PREDNISONE, ABIRATERONE, DEXAMETHASONE, Olaparib

Primary endpoint: Percentage of Participants With a Decrease of ≥50% in Prostatic Specific Antigen (PSA), Number of Participants with Adverse Events (AEs), Number of Participants Discontinuing Study Drug Due to AEs, Objective Response Rate (ORR) Based on Response Evaluation Criteria in Solid Tumors Version 1.1 (RECIST 1.1) Assessed by Blinded Independent Central Review (BICR)
Endpoint(s): Disease Control Rate (DCR) Based on RECIST 1.1 Assessed by BICR, Disease Control Rate (DCR) Based on Prostate Cancer Working Group 3 (PCWG3)-modified RECIST 1.1 Assessed by BICR, Overall Survival (OS), Duration of Response (DOR) Based on RECIST 1.1 Assessed by BICR, Duration of Response (DOR) Based on PCWG3-modified RECIST 1.1 Assessed by BICR, ORR Based on PCWG3-modified RECIST 1.1 Assessed by BICR, Time to PSA Progression, Radiographic Progression-free Survival (rPFS) Based on PCWG3-modified RECIST 1.1 Assessed by BICR, Composite Response Rate Defined as Any One of the Following: A. Response Based on RECIST 1.1; B. PSA Decrease of ≥50%; or C. Circulating Tumor-cell Count Conversion (Pembrolizumab + Olaparib Cohort Only)

Source: https://euclinicaltrials.eu/ctis-public/view/2023-506987-15-00